EU clinical trial 2025-521147-21-00: A Phase 1b/2 Open-Label, Multicenter Study of RMC-9805 with or without RMC-6236, in Combination with Other Anticancer Agents, in Patients with RAS G12D-Mutated Non-Small Cell Lung Cancer (NSCLC) – Subprotocol C
Protocol code: RMC-LUNG-101C
Sponsor: Revolution Medicines Inc. (Pharmaceutical company). Phase: Therapeutic exploratory (Phase II). Countries: Germany (ongoing, recruiting), Austria (authorised, recruiting), France (ongoing, recruiting), Netherlands (ongoing, recruiting), Czechia (authorised, recruiting), Greece (authorised, recruiting), Italy (ongoing, recruiting), Spain (ongoing, recruiting), Denmark (authorised, recruiting).
Therapeutic area(s): Diseases [C] - Respiratory Tract Diseases [C08]
Gender: Female, Male. Age: 18-64 years, 65+ years. Enrolment: 130.
Start date (EU): 2025-10-08. Decision date: 2025-10-06. Results received: No. Last updated: 2026-06-01.
Decision dates by country: NL: 2025-10-06, ES: 2025-10-07, FR: 2025-10-07, DK: 2025-10-07, AT: 2025-10-13, GR: 2025-10-06, CZ: 2025-10-06, IT: 2025-10-06, DE: 2025-10-07

Condition(s): Lung Cancer
Product: RMC-9805, PEMBROLIZUMAB, CARBOPLATIN, CISPLATIN, DARAXONRASIB (RMC-6236), DARAXONRASIB (RMC-6236), PEMETREXED

Primary endpoint: 1. Incidence of DLTs; Part 1 and Part 2 (Cohort C3 safety lead-in only)., 2. Incidence of TEAEs, TRAEs, SAEs, and clinically significant changes in vital signs, laboratory test values, and ECGs.
Endpoint(s): 1. Concentrations of RMC-9805 and RMC-6236 (if applicable) in blood over time., 2. ORR and DOR as per RECIST v1.1

Source: https://euclinicaltrials.eu/ctis-public/view/2025-521147-21-00